EU clinical trial 2024-510700-36-00: A Randomized, Open Label Phase II Clinical Trial of BMS-986012 in Combination with Carboplatin, Etoposide and Nivolumab as First-line Therapy in Extensive-Stage Small Cell Lung Cancer
Protocol code: CA001-050
Sponsor: Bristol Myers Squibb International Corporation (Pharmaceutical company). Phase: Therapeutic exploratory (Phase II). Countries: Romania (ended), Spain (ended), Belgium (ended), Netherlands (ended), Italy (ended), Poland (ended), Greece (ended).
Therapeutic area(s): Diseases [C] - Neoplasms [C04]
Gender: Female, Male. Age: 18-64 years, 65+ years. Enrolment: 135.
Status: Ended. Start date (EU): 2021-06-01. End date (EU): 2025-09-30. End date: 2025-11-28. Decision date: 2024-06-06. Results received: Yes. Last updated: 2025-11-19.
Decision dates by country: GR: 2024-07-22, RO: 2024-06-07, BE: 2024-06-07, NL: 2024-06-06, ES: 2024-06-10, IT: 2024-07-02, PL: 2024-07-05

Condition(s): Extensive-stage Small Cell Lung Cancer
Product: OPDIVO 10 mg/mL concentrate for solution for infusion., Anti-Fucosyl GM1 PET Tracer, ETOPOSIDE, CARBOPLATIN

Primary endpoint: Incidence of adverse events (AEs), Incidence of serious adverse events (SAEs), Incidence of AEs leading to discontinuation, Incidence of deaths, Progression-free survival (PFS) by blinded independent central review (BICR) based on Response Evaluation Criteria in Solid Tumors (RECIST) v1.1 criteria
Endpoint(s): 1. Progression-free survival rate (PFSR) [PFS by BICR based on RECIST v1.1 criteria], PFS by investigator based on RECIST v1.1 criteria, PFSR at 6 and 12 months. PFS by investigator based on RECIST v1.1 criteria., Objective response rate (ORR) based on RECIST v1.1 criteria, Time to response (TTR) based on RECIST v1.1 criteria, Duration of response (DOR) based on RECIST v1.1 criteria, Overall survival (OS), Overall survival rate (OSR), Immunogenicity of BMS-986012 measured by assessment of the presence of specific anti-drug antibodies (ADAs) to BMS-986012 (i.e. incidence of positive ADAs)

Source: https://euclinicaltrials.eu/ctis-public/view/2024-510700-36-00